EU clinical trial 2025-522377-12-00: Randomized study to compare first-line treatment with either continuous or intermittent cetuximab plus FOLFIRI in patients with RAS/BRAF-wild-type metastatic colorectal cancer (mCRC): AIO-KRK-0524 / FIRE-11
Protocol code: AIO-KRK-0524/FIRE-11
Sponsor: Charite Universitaetsmedizin Berlin KöR (Hospital/Clinic/Other health care facility). Phase: Therapeutic confirmatory (Phase III). Countries: Germany (authorised, recruitment pending).
Therapeutic area(s): Diseases [C] - Neoplasms [C04]
Gender: Female, Male. Age: 18-64 years, 65+ years. Enrolment: 267.
Status: Authorised, recruitment pending. Decision date: 2025-11-20. Results received: No. Last updated: 2026-06-02.

Condition(s): metastatic colorectal cancer
Product: FOLINIC ACID, CETUXIMAB, IRINOTECAN, FLUOROURACIL

Primary endpoint: Time to Failure of Strategy, which is defined as the time from randomization to failure of the treatment strategy. Failure of the treatment strategy is defined as o Disease progression on treatment o Death o Unacceptable toxicity o Occurrence of resistance mechanisms by ctDNA analysis
Endpoint(s): Efficacy: • Progression-free survival (PFS)1 to PFSN (defined as each PFS from treatment start with FOLFIRI+cetuximab to the first disease progression in the respective treatment period) • TFS stratified by ctDNA-guided progression or radiological progression • Overall survival (OS) • Objective response rate (ORR), Tumor response kinetics: • Dynamics of the tumor markers CEA and CA19-9 • Early tumour shrinkage, as determined by radiological imaging • Depth of radiological tumor response, as determined by radiological imaging, Circulating tumour DNA (ctDNA): • Prospective validation to use ctDNA based RAS/BRAF mutational analysis in addition to tissue-based RAS testing to exclude RAS/BRAF mutant tumors from treatment using the Guardant360 liquid biopsy assay • Define a threshold in ctDNA change predicting progressive disease during treatment break using the Guardant360 liquid biopsy assay • Validate the formerly defined ctDNA threshold using the Guardant360 liquid biopsy assay to induce re-use of FOLFIRI + Cetuximab, Safety: • Type, incidence, severity, and causal relationship to IMPs of non-serious adverse events and serious adverse events (severity evaluated according to CTCAE version 5.0), Quality of life: • QoL as assessed with the QoL questionnaire EQ-5D-5L

Source: https://euclinicaltrials.eu/ctis-public/view/2025-522377-12-00